EU clinical trial 2023-510295-31-00: A Phase 1b-2 Study to Evaluate Safety, Efficacy, Pharmacokinetics, and Pharmacodynamics of Various Regimens of Erdafitinib in Subjects with Metastatic or Locally Advanced Urothelial Cancer
Protocol code: 42756493BLC2002
Sponsor: Janssen Cilag International (Pharmaceutical company). Phase: Phase I and Phase II (Integrated)- Other. Countries: Spain (ongoing, recruitment ended).
Therapeutic area(s): Diseases [C] - Neoplasms [C04]
Gender: Female, Male. Age: 18-64 years, 65+ years. Enrolment: 7.
Status: Ongoing, recruitment ended. Start date (EU): 2018-09-24. Decision date: 2024-03-25. Results received: No. Last updated: 2026-06-10.

Condition(s): Metastatic or Locally Advanced Urothelial Cancer
Product: JNJ-42756493, JNJ-42756493, CISPLATIN, JNJ-42756493, JNJ-63723283, CARBOPLATIN, JNJ-63723283

Primary endpoint: Phase 1b (Dose Escalation) - Frequency and type of dose-limiting toxicity (DLT)., Phase 2 (Dose Expansion) - Overall response rate (ORR) (partial response [PR] or better) per Response Evaluation Criteria in Solid Tumors (RECIST) 1.1 by investigator assessment - Incidence of AEs.

Source: https://euclinicaltrials.eu/ctis-public/view/2023-510295-31-00